EU clinical trial 2024-511665-11-00: (22578) An open-label, non-randomized, multi-center, phase 4 pharmacokinetic study to evaluate the systemic exposure after bilateral intravitreal administration of high dose (8 mg) aflibercept in adults with diabetic macular edema or neovascular age-related macular degeneration
Protocol code: 22578
Sponsor: Bayer AG (Pharmaceutical company). Phase: Therapeutic use (Phase IV). Countries: Czechia (ended), Slovakia (ended), Hungary (ended).
Therapeutic area(s): Diseases [C] - Eye Diseases [C11]
Gender: Female, Male. Age: 18-64 years, 65+ years. Enrolment: 45.
Status: Ended. Start date (EU): 2024-08-29. End date (EU): 2025-10-14. Decision date: 2024-08-19. Results received: No. Last updated: 2025-02-25.
Decision dates by country: CZ: 2024-08-20, SK: 2024-08-19, HU: 2024-08-27

Condition(s): Neovascular age-related macular degeneration (nAMD), Diabetic macular edema (DME)
Product: Eylea 114.3 mg/ml solution for injection

Primary endpoint: Maximum observed concentration (Cmax) of free aflibercept

Source: https://euclinicaltrials.eu/ctis-public/view/2024-511665-11-00